EU clinical trial 2024-515936-62-00: A phase 1/2 multiple-indication biomarker, safety, and efficacy study in advanced or metastatic Gastrointestinal cancers exploring treatment comBinations with peLarEorep and aTezolizumab (GOBLET)
Protocol code: REO 029
Sponsor: Oncolytics Biotech Inc. (Pharmaceutical company). Phase: Phase I and Phase II (Integrated)- Other. Countries: Germany (ongoing, recruitment ended).
Therapeutic area(s): Diseases [C] - Neoplasms [C04]
Gender: Female, Male. Age: 18-64 years, 65+ years. Enrolment: 102.
Status: Ongoing, recruitment ended. Start date (EU): 2024-10-10. Decision date: 2024-10-10. Results received: No. Last updated: 2026-07-23.
Decision dates by country: DE: 2024-12-17

Condition(s): Patients with advanced or metastatic gastrointestinal (GI) tumors.
Product: Tecentriq 840 mg concentrate for solution for infusion, pelareorep

Primary endpoint: ORR (CR, PR) assessed by the investigator according to RECIST v1.1 at week 16 (within each cohort) cohort 5 (Phase 1b) Safety: To evaluate the safety and tolerability of 1) mFOFIRINOX plus pelareorep and atezolizumab (Arm A) and 2) mFOLFIRINOX plus pelareorep (Arm B). Efficacy: To evaluate the response to treatment measured by ORR in 1) patients treated with mFOLFIRINOX plus pelareorep and atezolizumab (Arm A) and 2) patients treated with mFOLFIRINOX plus pelareorep (Arm B).
Endpoint(s): Efficacy: - PFS defined as the duration from the date of enrollment to the date of progressive disease or death from any cause. - OS defined as the time from randomization to death from any cause., - Safety assessments from enrollment to 90 days after last dose of study treatment will include: - Serious and non-serious AEs (clinical and laboratory), laboratory parameters, treatment exposure (total delivered dose and dose modifications), and reasons for treatment discontinuation.

Source: https://euclinicaltrials.eu/ctis-public/view/2024-515936-62-00